EU clinical trial 2023-508954-25-00: A Phase 1/2 First-in-human Study of BMS-986288 Alone and in Combination with Nivolumab in Advanced Malignant Tumors
Protocol code: CA043-001
Sponsor: Bristol Myers Squibb International Corporation (Pharmaceutical company). Phase: Phase I and Phase II (Integrated)- First administration to humans. Countries: Spain (ended), France (ended), Italy (ended).
Therapeutic area(s): Diseases [C] - Neoplasms [C04]
Gender: Female, Male. Age: 18-64 years, 65+ years. Enrolment: 96.
Status: Ended. Start date (EU): 2022-05-11. End date (EU): 2024-08-20. End date: 2024-08-31. Decision date: 2024-01-16. Results received: Yes. Last updated: 2024-06-19.
Decision dates by country: FR: 2024-01-16, IT: 2024-01-17, ES: 2024-01-17

Condition(s): Advanced solid tumors (squamous cell carcinoma of the head and neck (SCCHN), non-small cell lung cancer (NSCLC), cutaneous melanoma, triple-negative breast cancer (TNBC), renal cell carcinoma (RCC), urothelial carcinoma, gastric, esophageal, cervical, and colorectal cancer (CRC)).
Product: OPDIVO 10 mg/mL concentrate for solution for infusion., Stivarga 40 mg film-coated tablets, anti-CTLA-4 NF Probody® mAb

Primary endpoint: For Part 1, 2A, 2B: Incidence of Adverse Events (AEs), Serious Adverse Events (SAEs), AEs meeting protocol-defined Dose Limiting Toxicities (DLT) Criteria, AEs leading to discontinuation, death and laboratory abnormalities, For Part 2C: Objective Response Rate (ORR) per Response Evaluation Criteria in Solid Tumors (RECIST) v1.1 by BICR
Endpoint(s): For Part 1, 2A, 2B: Maximum Observed Concentration (Cmax) of BMS-986288, For Part 1, 2A, 2B: Time of Maximum Observed Concentration (Tmax) of BMS-986288, For Part 1, 2A, 2B: Area Under the Concentration-Time Curve From Time Zero to Time of Last Quantifiable Concentration AUC(0-T) of BMS-986288, For Part 1, 2A, 2B: Area Under the Concentration-Time Curve in one Dosing Interval AUC(TAU) of BMS-986288, For Part 1, 2A, 2B: Observed Concentration at the end of a Dosing Interval (Ctau) of BMS- 986288, For Part 1, 2A, 2B: Trough Observed Concentrations (Ctrough) of BMS-986288, For Part 1, 2A, 2B: Total Body Clearance (CLT) of BMS-986288, For Part 1, 2A, 2B: Average Concentration Over a Dosing Interval at Steady State (Cavgss) of BMS-986288, For Part 1, 2A, 2B: Accumulation Index (AI) of BMS-986288, For Part 1, 2A, 2B: Terminal Half-Life (T-HALF) of BMS-986288, For Part 1, 2A, 2B: Objective Response Rate (ORR) of Participants, For Part 1, 2A, 2B: Duration of Response (DOR) of Participants, For Part 1, 2A, 2B: Progression-Free Survival (PFS) of Participants, For Part 1, 2A, 2B: Time to Response (TTR) of Participants, For Part 2C: Objective Response Rate (ORR) by RECIST V1.1 by BICR, For Part 2C: Duration of Response (DOR) by RECIST V1.1 by BICR, For Part 2C: Progression-Free Survival (PFS) by RECIST V1.1 by BICR, For Part 2C: Overall Survival (OS) by RECIST V1.1 by BICR, For Part 2C: Incidence of Adverse Events (AEs), Serious Adverse Events (SAEs), AEs meeting protocol-defined Dose Limiting Toxicities (DLT) Criteria, AEs leading to discontinuation and death.

Source: https://euclinicaltrials.eu/ctis-public/view/2023-508954-25-00